EU clinical trial 2024-514569-20-00: SURE-02_An open label, single-arm, phase 2 study of perioperative pembrolizumab plus sacituzumab govitecan, and bladder-saving approach, for patients with muscle-invasive bladder cancer who cannot receive or refuse cisplatin-based chemotherapy
Protocol code: SURE-02
Sponsor: Ospedale San Raffaele S.r.l. (Hospital/Clinic/Other health care facility). Phase: Therapeutic exploratory (Phase II). Countries: Italy (ongoing, recruitment ended).
Therapeutic area(s): Diseases [C] - Neoplasms [C04]
Gender: Female, Male. Age: 18-64 years, 65+ years. Enrolment: 48.
Status: Ongoing, recruitment ended. Start date (EU): 2022-09-15. Decision date: 2024-10-28. Results received: No. Last updated: 2026-04-14.

Condition(s): muscle-invasive bladder cancer
Product: Trodelvy 200 mg powder for concentrate for solution for infusion, KEYTRUDA 25 mg/mL concentrate for solution for infusion

Primary endpoint: clinical CR-rate.
Endpoint(s): Bladder-intact event-free survival (BI-EFS);, Pathological response-rate., Safety (CTCAE v-5.0), Overall survival (OS).

Source: https://euclinicaltrials.eu/ctis-public/view/2024-514569-20-00